EU clinical trial 2024-515627-10-00: A double-blind, randomised, placebo-controlled, first-in-human (FIH) Phase I/IIa, multi-centre trial to assess safety, tolerability, and immune response of single and multiple ascending doses of TOL2 (Immune Tolerising Agent) in patients with generalised myasthenia gravis
Protocol code: TLZ-C-001
Sponsor: Bonsai Biotherapeutics AB (Pharmaceutical company). Phase: Phase I and Phase II (Integrated)- First administration to humans. Countries: Germany (authorised, recruitment pending), Denmark (not authorised), Sweden (authorised, recruitment pending).
Therapeutic area(s): Diseases [C] - Immune System Diseases [C20]; Diseases [C] - Nervous System Diseases [C10]
Gender: Female, Male. Age: 18-64 years, 65+ years. Enrolment: 55.
Decision date: 2025-02-07. Results received: No. Last updated: 2026-07-03.
Decision dates by country: DK: 2025-02-12, SE: 2025-02-07, DE: 2025-02-10

Condition(s): generalised myasthenia gravis
Product: Prednisolon Pfizer 10 mg tabletter, Glucos Fresenius Kabi 50 mg/ml, infusionsvätska, lösning, ALBUMIN, Prednisolon Pfizer 2,5 mg tabletter, Glucose 5 % "Fresenius" - Infusionslösung, IMMUNOGLOBULINS, NORMAL HUMAN, FOR INTRAVASCULAR ADM., Glucos Fresenius Kabi, Prednisolon Pfizer 5 mg tabletter

Primary endpoint: Incidence and severity of adverse events (AEs) using Common Terminology Criteria for Adverse Events (CTCAE) version 5.0 with special focus on exacerbation of MG or myasthenic crisis, immune-complex related adverse reactions, CRS, which are considered AEs of special interest (AESIs)., Incidence and intensity of local tolerability reactions (infusion site reactions and signs of vascular toxicity)., Time course of local tolerability reactions., Changes from baseline in vital signs, electrocardiogram (ECG), safety laboratory parameters (clinical chemistry, haematology, coagulation, and urinalysis), physical examination findings and use of concomitant medications including rescue medication.
Endpoint(s): PK parameters, SAD part •AUClast • Cmax •Tmax If possible: •AUCinf •T1/2(z) •CL •Vz •Vss Dose proportionality after single dose based on AUC and Cmax. PK parameters, MAD part •AUClast •AUCtau •Cmax •Tmax If possible: •T1/2(z) •CL •Vz •Vss •Ctrough from Day 5 Dose proportionality after multiple doses, based on AUC at steady state (AUCtau,ss) and Cmax. Accumulation ratio for AUC and Cmax, Changes from baseline in: •Anti-AChR antibody levels •Anti-drug antibodies (ADAs), Changes from baseline in: •Myasthenia Gravis-Activities of Daily Living (MG-ADL) score •Quantitative-Myasthenia Gravis (QMG) score •Myasthenia Gravis Composite score (MGC) •Myasthenia Gravis Quality of Life Scale (MGQoL15r [revised version]) score., Discontinuation or reduction in dose of concomitant use of immunosuppressant therapy or symptomatic MG therapy

Source: https://euclinicaltrials.eu/ctis-public/view/2024-515627-10-00